EU clinical trial 2025-524602-15-00: Diving into the noradrenergic system : Role of the alpha2C-adrenergic receptors NA2C-TEP-IRM
Protocol code: 69HCL24_1120
Sponsor: Hospices Civils De Lyon (Hospital/Clinic/Other health care facility). Phase: Therapeutic exploratory (Phase II). Countries: France (ongoing, recruiting).
Therapeutic area(s): Diseases [C] - Nervous System Diseases [C10]
Gender: Female, Male. Age: 18-64 years, 65+ years. Enrolment: 165.
Status: Ongoing, recruiting. Start date (EU): 2026-06-29. Decision date: 2026-04-24. Results received: No. Last updated: 2026-04-24.

Condition(s): Neurology
Product: [11C]ORM-13070

Primary endpoint: Derived from the PET data, the binding potential (BPND) parametric maps will be calculated using compartmental modelling techniques. Derived from the MRI data, the LC will be defined with a semi-automatic method from the MRI sequence sensitive to neuromelanin, and its signal intensity will be calculated for each participant as previously described (Laurencin et al., 2024a)
Endpoint(s): Correlation coefficients between regional BPND and contrast ratio in the LC (signal intensity)., Correlation coefficients between PET-MRI indices of the noradrenergic system (α₂C BPND and contrast ratio in the LC) and performance: · cognitive: MoCA, TMT A/B, Stroop; · memory: RL/RI-16, digit memory (span); · Language: verbal fluency; · Visuospatial: VOSP score; · Olfactory: Sniffin' Sticks (TDI score); · Affective/Mood: apathy (LARS), depression (BDI-II), anxiety (STAI), fatigue (PDFS-16), impulsivity (UPPS) · Sleep: Epworth, RBDSQ; · Dysautonomic: SCOPA-AUT score; · Pain (EVA score), Correlation coefficients between PET-MRI indices of the noradrenergic system (α₂C BPND and contrast ratio in the LC) and clinical and behavioral variables: Disease severity; Cognition; Memory; Language; Visuospatial ability; Olfactory, Affective/Mood; Sleep ; Dysautonomia ; Pain

Source: https://euclinicaltrials.eu/ctis-public/view/2025-524602-15-00